EU clinical trial 2024-514979-17-04: PembrolizuMab beyond RECIST progression and oral metroNOmic cyclophosphamide in meTAstatic UROthelial cancer: a single-arm, monocentre, phase 2 trial: minotaURO study
Sponsor: I.F.O. Istituti Fisioterapici Ospitalieri (Hospital/Clinic/Other health care facility). Phase: Therapeutic exploratory (Phase II). Countries: Italy (ended).
Therapeutic area(s): Diseases [C] - Neoplasms [C04]
Gender: Female, Male. Age: 18-64 years, 65+ years. Enrolment: 43.
Status: Ended. End date (EU): 2025-10-08. Decision date: 2025-02-24. Results received: No. Last updated: 2025-02-24.

Condition(s): metastatic urothelial cancer
Product: Endoxan®

Primary endpoint: Non progressive rate at 6 months
Endpoint(s): • The secondary end points are: duration of response (DOR); disease control rate (DCR); time to progression (TTP); OS; safety. Exploratory Endpoints: To identify biomarkers in blood and tissue samples to evaluate the mechanism of immune-resistance (Immunogenicity of pembrolizumab given in combination with metronomic cyclophoshamide

Source: https://euclinicaltrials.eu/ctis-public/view/2024-514979-17-04